EU clinical trial 2023-507388-21-00: Early Reperfusion Therapy with Intravenous Thrombolysis for Recovery of VISION in Acute Central Retinal Artery Occlusion (REVISION) - A double-blind randomized placebo-controlled phase III trial
Protocol code: REVISION
Sponsor: Universitaetsklinikum Tuebingen AöR (Hospital/Clinic/Other health care facility). Phase: Therapeutic confirmatory (Phase III). Countries: Germany (ended).
Therapeutic area(s): Diseases [C] - Eye Diseases [C11]
Gender: Female, Male. Age: 18-64 years, 65+ years. Enrolment: 1422.
Status: Ended. Start date (EU): 2022-09-08. End date (EU): 2026-04-29. Decision date: 2023-10-18. Results received: No. Last updated: 2026-03-19.

Condition(s): Acute non-arteritic central retinal artery occlusion (CRAO)
Product: Tenecteplase Placebo, Metalyse 5 000 units (25 mg) powder for solution for injection

Primary endpoint: Primary efficacy endpoint of the interventional study: Functional recovery to best corrected visual acuity (BCVA) of Logarithm of the Minimum Angle of Resolution (LogMAR) ≤ 0.5 (normal to mild vision impairment according to WHO ICD-11) in the affected eye at Visit (V) 3 (30 ± 5 days), intention-to-treat (ITT) analysis
Endpoint(s): Functional recovery to LogMAR ≤ 0.5 at V3 (30 ± 5 days) (dichotomized) in the per protocol population, Functional recovery to LogMAR ≤ 0.5 at V2 (18 – 72 hours), and V4 (90 ± 10 days) (dichotomized), Shift in visual outcome categories (according to WHO ICD-11 (WHO, 2019): normal vision (LogMAR ≤ 0), mild visual impairment (LogMAR > 0 and ≤ 0.5), moderate visual impairment (LogMAR > 0.5 and ≤ 1.0), severe visual impairment (LogMAR > 1.0 and ≤ 1.3), counting fingers (LogMAR > 1.3 and ≤ counting fingers), hand motion or light perception, and no light perception) at V2, V3, and V4, Dichotomized analysis of visual outcome: ‘normal vision to moderate visual impairment’ vs. ‘severe visual impairment or functional blindness’ and ‘normal vision to severe visual impairment’ vs. ‘functional blindness’ at V2, V3, and V4, Kinetic visual field using III4e mark at V3 and V4 (as a continuous variable), Central retinal artery recanalization assessed using OCTA of the optic nerve head and the macula at V2, V3, and V4 (continuous), Retinal arterial perfusion assessed using fluorescein angiography at V3 and V4 (continuous), NEI-VFQ-25 at V3 and V4 (continuous), NIHSS at V2 (continuous), mRS at V3, and V4 (dichotomized into categories 0 – 1 (excellent outcome) vs. 2 – 6, 0 – 2 (functional independence) vs. 3 – 6, and shift analysis), Fraction of patients with, number, and volume of acute ischemic lesions on follow-up diffusionweighted (DWI) cranial magnetic resonance imaging (MRI) at V2 (dichotomous and continuous, respectively), Any bleeding until V2 by Common Terminology Criteria for Adverse Events (CTCAE) v5.0 classification of adverse events (AE), i.e., mild, moderate, severe, life-threatening, leading to death.

Source: https://euclinicaltrials.eu/ctis-public/view/2023-507388-21-00